EU clinical trial 2024-515499-12-00: International phase 3 trial in Philadelphia chromosome-positive acute lymphoblastic leukemia (Ph+ ALL) testing imatinib in combination with two different cytotoxic chemotherapy backbones
Protocol code: EsPhALL2017/COGAALL1
Sponsor: Universita Degli Studi Di Milano Bicocca (Educational Institution). Phase: Therapeutic confirmatory (Phase III). Countries: Germany (ongoing, recruitment ended), Sweden (ongoing, recruitment ended), Denmark (ongoing, recruitment ended), Italy (ongoing, recruitment ended), Austria (ongoing, recruitment ended), Czechia (ongoing, recruitment ended), Belgium (ongoing, recruitment ended), Poland (ongoing, recruitment ended), Netherlands (ongoing, recruitment ended), Finland (ongoing, recruitment ended), Spain (ongoing, recruitment ended), France (ongoing, recruitment ended).
Therapeutic area(s): Diseases [C] - Neoplasms [C04]
Gender: Female, Male. Age: 0-17 years, 18-64 years. Enrolment: 306.
Status: Ongoing, recruitment ended. Start date (EU): 2017-10-02. Decision date: 2024-10-25. Results received: No. Last updated: 2026-06-11.
Decision dates by country: AT: 2024-10-29, BE: 2024-10-25, CZ: 2024-10-30, DK: 2024-10-27, FI: 2024-10-28, FR: 2024-11-12, IT: 2024-11-05, ES: 2024-10-25, SE: 2024-10-25, NL: 2024-10-25, PL: 2024-10-28, DE: 2024-10-25

Condition(s): Acute lymphoblastic leukemia, Acute lymphoblastic leukemia, Acute lymphoblastic leukemia, Acute lymphoblastic leukemia, Acute lymphoblastic leukemia
Product: ETOPOSIDE, CYTARABINE, Decortin H 5 mg töflur, CYTARABINE, HYDROCORTISONE SODIUM SUCCINATE, IFOSFAMIDE, DAUNORUBICIN HYDROCHLORIDE, CYCLOPHOSPHAMIDE, DEXAMETHASONE, METHOTREXATE, Vincristina Teva Italia 1 mg/ml soluzione iniettabile, DOXORUBICIN HYDROCHLORIDE, DELTACORTENE 25 mg compresse, METHOTREXATE, Erwinase 10 000 U polvere per soluzione iniettabile/per infusione., IMATINIB, METHOTREXATE, PEGASPARGASE, MERCAPTOPURINE, TIOGUANINE

Primary endpoint: The primary endpoint, DFS, is defined as the time from randomization to first event (relapse, second malignancy, or death in complete remission) or time to last followup for patients without events, The primary endpoint, DFS, is defined as the time from randomization to first event (relapse, second malignancy, or death in complete remission) or time to last followup for patients without events, The primary endpoint, DFS, is defined as the time from randomization to first event (relapse, second malignancy, or death in complete remission) or time to last followup for patients without events, The primary endpoint, DFS, is defined as the time from randomization to first event (relapse, second malignancy, or death in complete remission) or time to last followup for patients without events

Source: https://euclinicaltrials.eu/ctis-public/view/2024-515499-12-00